EU clinical trial 2024-512611-53-00: A Phase 2B, Multicenter, 30-week, Prospective, Cross-over, Double-blind, Randomized, Placebo-controlled Study Followed by a 52-Week Open-label Extension Study to Evaluate the Efficacy and Safety of Basimglurant Adjunctive to Ongoing Anticonvulsive Therapy in Children, Adolescents, and Young Adults with Seizures Associated with Tuberous Sclerosis Complex
Protocol code: NOE-TSC-201
Sponsor: Noema Pharma AG (Pharmaceutical company). Phase: Therapeutic exploratory (Phase II). Countries: Spain (ended), Italy (ended), Poland (ended).
Therapeutic area(s): Diseases [C] - Nervous System Diseases [C10]
Gender: Female, Male. Age: 0-17 years, 18-64 years. Enrolment: 31.
Status: Ended. Start date (EU): 2023-06-30. End date (EU): 2025-03-17. End date: 2025-04-28. Decision date: 2024-09-06. Results received: Yes. Last updated: 2025-02-03.
Decision dates by country: ES: 2024-09-09, PL: 2024-09-06, IT: 2024-09-09

Condition(s): Tuberous Sclerosis Complex
Product: Placebo to Basimglurant (Microcrystalline Cellulose Spheres (Vivapur 1000) and hard Gelatin Capsule, Opaque white body/Opaque white cap, Size 1), Basimglurant, Basimglurant

Primary endpoint: Monthly seizure counts of countable seizure types (per 28 days) during the 12-week treatment period in Period 2 and Period 4
Endpoint(s): Changes from baseline in Sheehan Disability Scale(SDS) score at Week 16 in Period 2 and at Week 30 in Period 4, Caregiver Global Impression of Change (CGIC) score at Week 16 in Period 2 and Week 30 in Period 4., Monthly seizure free days (per 28 days) during the 12-week treatment period in Period 2 and Period 4., Seizure 25% response defined as ≥25% reduction from baseline in monthly seizure counts of countable seizure types during the 12-week treatment period in Periods 2 and 4., Seizure 50% response defined as ≥50% reduction from baseline in monthly seizure counts of countable seizure types during the 12-week treatment period in Periods 2 and 4., Seizure 75% response defined as ≥75% reduction from baseline in monthly seizure counts of countable seizure types during the 12-week treatment period in Periods 2 and 4., >Adverse events, Absolute values and changes from baseline in vital signs, physical examination, electrocardiograms, and clinical laboratory test parameters. >Treatment delays, dose reductions, and dose discontinuations. >S-STS score for suicidal ideation. >Seizure count by types., >Escalation (Yes/No) to each dose level during the dose escalation in Periods 2 and 4. >Toleration (Yes/No) of each dose level during the dose escalation in Periods 2 and 4. >Adverse events and other safety and tolerability parameters during the OLE period.

Source: https://euclinicaltrials.eu/ctis-public/view/2024-512611-53-00